EU clinical trial 2024-514788-24-00: Clinical study to compare the therapeutic effects of two ointments with active substances betamethasone dipropionate and salicylic acid and of one ointment without active substances for patients with chronic stable plaque poriasis
Protocol code: 20-01/BetaSal-S
Sponsor: Dermapharm AG (Pharmaceutical company). Phase: Therapeutic confirmatory (Phase III). Countries: Germany (ended).
Therapeutic area(s): Diseases [C] - Skin and Connective Tissue Diseases [C17]
Gender: Female, Male. Age: 18-64 years, 65+ years. Enrolment: 306.
Status: Ended. Start date (EU): 2022-09-20. End date (EU): 2025-08-25. Decision date: 2024-08-12. Results received: No. Last updated: 2025-02-06.

Condition(s): Chronic stable plaque psoriasis

Source: https://euclinicaltrials.eu/ctis-public/view/2024-514788-24-00